EU clinical trial 2025-522563-15-00: Phase 2/3 Open Label Randomized Study of Telisotuzumab Adizutecan in Combination with FOLFOX Compared to Standard of Care in Subjects with First-Line Metastatic Pancreatic Ductal Adenocarcinoma - AndroMETa-PDAC-288
Protocol code: M25-288
Sponsor: AbbVie Deutschland GmbH & Co. KG (Pharmaceutical company). Phase: Phase II and Phase III (Integrated). Countries: Portugal (authorised, recruitment pending), Spain (authorised, recruitment pending), France (authorised, recruitment pending), Italy (authorised, recruitment pending), Germany (authorised, recruitment pending), Austria (authorised, recruitment pending).
Therapeutic area(s): Diseases [C] - Neoplasms [C04]
Gender: Female, Male. Age: 18-64 years, 65+ years. Enrolment: 194.
Status: Authorised, recruitment pending. Decision date: 2026-07-06. Results received: No. Last updated: 2026-07-10.
Decision dates by country: AT: 2026-07-10, FR: 2026-07-06, DE: 2026-07-10, IT: 2026-07-08, PT: 2026-07-07, ES: 2026-07-10

Condition(s): Metastatic Pancreatic Ductal Adenocarcinoma; PDAC
Product: CALCIUM FOLINATE, IRINOTECAN, FLUOROURACIL, OXALIPLATIN, Telisotuzumab adizutecan

Primary endpoint: Phase 2 and Phase 3: Objective response (OR) assessed by Blinded Independent CentralReview (BICR) per Response Evaluation Criteria in Solid Tumors (RECIST) v1.1, Phase 3: Overall Survival
Endpoint(s): Phase 2 and Phase 3: Progression-Free Survival (PFS) assessed by BICR per RECIST v1.1, Phase 2 and Phase 3: Duration Of Response (DoR) Assessed by BICR per RECIST v1.1, Phase 2 and Phase 3: Clinical Benefit (CB) assessed by BICR per RECIST v1.1, Phase 2 : Overall Survival, Phase 3: Change from baseline and time to deterioration in scales/items of the EORTC QLQ-C30 and EORTC QLQ-PAN26, Phase 3: Change in Selected items of the Patient-Reported Outcomes version of the Common Terminology Criteria for Adverse Events (PRO-CTCAE), Phase 3: Change in GP5 item of the Functional Assessment of Cancer Therapy-General (FACT-G), Phase 3: Change in Selected items of Patient Global Impression of Severity (PGIS)/Patient Global Impression of Change (PGIC), Phase 3: Change from baseline in European Quality of Life 5 Dimensions (EQ-5D-5L) utility index and visual analog scale (VAS)

Source: https://euclinicaltrials.eu/ctis-public/view/2025-522563-15-00